EU clinical trial 2025-521506-17-01: iSTOP-CP: intranasal Stem Cells to treat Perinatal brain injury to combat Cerebral Palsy
Sponsor: Universitair Medisch Centrum Utrecht (Hospital/Clinic/Other health care facility). Phase: Therapeutic exploratory (Phase II). Countries: Netherlands (authorised, recruitment pending).
Therapeutic area(s): Diseases [C] - Congenital, Hereditary, and Neonatal Diseases and Abnormalities [C16]
Gender: Female, Male. Age: 0-17 years. Enrolment: 162.
Status: Authorised, recruitment pending. Decision date: 2026-07-06. Results received: No. Last updated: 2026-07-06.

Condition(s): Hypoxic-ischemic brain injury (HIBI) because of Perinatal Asphyxia (PA) or Perinatal arterial ischemic stroke (PAIS)
Product: MSC, marrow (bone-marrow derived mesenchymal stromal cell), POTASSIUM CHLORIDE (RVG051680; SUB12559MIG), 10% Human Serum Albumin (RVG 103594; SUB20344)

Primary endpoint: Bayley-IV-NL motor score assessed at 24 months of age.
Endpoint(s): Cognitive development at 2 years, assessed using the cognitive composite Score of the Bayley-IV-NL, At 2 years of age, sensorineural disability will be assessed based on the presence of at least one of the following: cerebral palsy (GMFCS ≥1), neuromotor delay (Bayley-IV-NL motor score < -1 SD), cognitive delay (Bayley-IV-NL cognitive score < -1 SD), epilepsy (per ILAE definition), or moderate to severe visual or hearing impairment due to PA or PAIS., At 3–4 months of age, safety will be evaluated by tracking adverse events occurring between IN-MSC administration and 3 months, and by assessing potential effects on the brain, including tumor formation, through MRI at 52 weeks postmenstrual age., Between 3 and 24 months of age, safety will be monitored by tracking serious adverse events (e.g., seizures, unplanned hospital visits), use of additional medications, and any unexpected deviations in neurological development based on earlier MRI findings, using standardized assessments (GMA with MOS-R and HINE), For infants with HIBI due to PA, the effect of IN-MSCs on white matter integrity will be assessed at 52 weeks PMA using DTI-MRI and tract-based FA analysis. For infants with PAIS, changes in brain tissue volume between the early neonatal MRI (<8 days) and MRI at 52 weeks PMA will be evaluated., Differences in health-related quality of life (HRQoL) for patients and families will be assessed at 3, 9–12, and 24 months using questionnaires: EQ-5D-5L, PCL-5, LTO, KLIK Pain, CIS-4, and WEMWBS for parents/caregivers, and EQ-TIPS and PedsQL-Infant for infants, The economic impact at 24 months will be evaluated through a Health Technology Assessment, including a cost of illness study, societal return on investment, cost-effectiveness analysis, and budget impact analysis.

Source: https://euclinicaltrials.eu/ctis-public/view/2025-521506-17-01